EU clinical trial 2022-503136-13-00: A First-in-Human Study of ABBV-525 (MALT1 Inhibitor) in B-Cell Malignancies
Protocol code: M23-324
Sponsor: Abbvie Deutschland GmbH & Co. KG (Pharmaceutical company). Phase: Human Pharmacology (Phase I)- First administration to humans. Countries: Belgium (ongoing, recruitment ended), Germany (ended), Spain (ended), France (ongoing, recruitment ended).
Therapeutic area(s): Diseases [C] - Neoplasms [C04]
Gender: Female, Male. Age: 18-64 years, 65+ years. Enrolment: 88.
Start date (EU): 2024-02-29. Decision date: 2023-10-17. Results received: No. Last updated: 2026-03-24.
Decision dates by country: DE: 2023-10-18, ES: 2023-10-23, BE: 2023-10-17, FR: 2023-10-23

Condition(s): various B-cell malignancies

Source: https://euclinicaltrials.eu/ctis-public/view/2022-503136-13-00